EU clinical trial 2024-514411-95-00: Phase II Clinical Trial to Evaluate the Safety and Feasibility of Senolytic Therapy in Alzheimer's Disease: "Senolytic Therapy to Modulate the Progression of Alzheimer's Disease (SToMP-AD)" Study
Protocol code: IRB00067429
Sponsor: Wake Forest University Health Sciences (Educational Institution). Phase: Therapeutic exploratory (Phase II). Countries: Spain (not authorised).
Therapeutic area(s): Diseases [C] - Nervous System Diseases [C10]
Gender: Female, Male. Age: 18-64 years, 65+ years. Enrolment: 24.
Status: Not authorised. Decision date: 2024-12-02. Results received: No. Last updated: 2024-12-02.

Condition(s): Amnestic mild cognitive impairment (aMCI, single or multi-domain) or early stage Alzheimer's Disease
Product: QUERCETIN, Dasatinib Teva 100 mg comprimidos recubiertos con película EFG

Primary endpoint: Safety of 12 weeks of treatment with dasatinib and quercetin as compared to placebo, as measured by incidence of AEs and SAEs from baseline to week 48. Treatment with Dasatinib + Quercetin is expected to be as safe as placebo when comparing incidence of SAEs between groups. AEs and SAEs will be collected at each in-person visit and at scheduled telephone visits.
Endpoint(s): Change in blood senescence marker SASP composite score from baseline to week 12. Biomarker analysis will include a composite score generated from ten core SASP factors (i.e., IL-9, IL-1a, IL-6, IL-2, MMP-9, MMP-12, MMP-2, FGF-2, IL-1RA, and GM-CSF). Blood collections will be obtained at baseline, after 12 weeks treatment of D+Q (or placebo), and every 12 weeks during follow up visits under fasted conditions., Change in p16INK4a+/CD3+ T cells in blood from baseline to week 12. The biomarker analyses will include quantifying senescent cells in blood (p16INK4a+/CD3+ T cells). Blood collections will be obtained at baseline, after 12 weeks treatment of D+Q (or placebo), and every 12 weeks during follow up visits under fasted conditions., Change in CDR Sum of Boxes (CDR-SB) slope from screening to week 48. The CDR will be performed at screening, at week 12 of treatment and end of study at week 48., Change in ADAS-Cog slope from baseline to week 48.

Source: https://euclinicaltrials.eu/ctis-public/view/2024-514411-95-00